EU clinical trial 2025-520631-17-00: A Study to Assess the Safety of RG6496 in Huntington’s Disease Gene Expansion Carriers with the Selected Genetic Variant (POINT-HD)
Protocol code: BP45378
Sponsor: F. Hoffmann-La Roche AG (Pharmaceutical company). Phase: Human Pharmacology (Phase I)- First administration to humans. Countries: Italy (ended), Poland (ended), Denmark (ended), Germany (ended), Portugal (ended), Spain (ended).
Therapeutic area(s): Diseases [C] - Nervous System Diseases [C10]
Gender: Female, Male. Age: 18-64 years. Enrolment: 43.
Status: Ended. End date (EU): 2026-07-06. Decision date: 2026-05-11. Results received: No. Last updated: 2026-07-10.
Decision dates by country: DE: 2026-05-12, ES: 2026-05-18, PL: 2026-05-15, DK: 2026-05-11, IT: 2026-05-11, PT: 2026-05-12

Condition(s): Huntington’s Disease Gene Expansion Carriers

Source: https://euclinicaltrials.eu/ctis-public/view/2025-520631-17-00